EU clinical trial 2022-502888-38-00: J4E-MC-IMMB: A Master Protocol for Randomized, Controlled, Phase 2 Clinical Trials of Multiple Interventions for the Treatment of Adults with Moderate-to-Severe Atopic Dermatitis; J4E-MC-FR01: A Phase 2, Randomized, Double-Blind, Parallel-Group, Placebo-Controlled, 52-Week Study to Evaluate the Efficacy and Safety of LY3454738 in the Treatment of Adult Patients with Moderate-to-Severe Atopic Dermatitis
Sponsor: Eli Lilly & Co. (Pharmaceutical company). Phase: Therapeutic exploratory (Phase II). Countries: Italy (not authorised), Poland (ended), Hungary (ended).
Therapeutic area(s): Phenomena and Processes [G] - Immune system processes [G12]; Diseases [C] - Skin and Connective Tissue Diseases [C17]; Diseases [C] - Immune System Diseases [C20]
Gender: Female, Male. Age: 18-64 years, 65+ years. Enrolment: 94.
Status: Ended. Start date (EU): 2023-09-25. End date (EU): 2024-12-03. End date: 2025-03-14. Decision date: 2023-08-11. Results received: Yes. Last updated: 2026-07-01.
Decision dates by country: IT: 2023-08-11, HU: 2023-08-11, PL: 2023-08-14

Condition(s): Atopic dermatitis
Product: SODIUM CHLORIDE SOLUTION 0.9%

Primary endpoint: Percentage of Participants Achieving Eczema Area and Severity Index (EASI) 75

Source: https://euclinicaltrials.eu/ctis-public/view/2022-502888-38-00